EU clinical trial 2023-505034-10-00: AN OPEN-LABEL, MULTICENTER, GLOBAL PHASE II BASKET STUDY OF ENTRECTINIB FOR THE TREATMENT OF PATIENTS WITH LOCALLY ADVANCED OR METASTATIC SOLID TUMORS THAT HARBOR NTRK1/2/3, ROS1, OR ALK GENE REARRANGEMENTS
Protocol code: GO40782
Sponsor: F. Hoffmann-La Roche AG (Pharmaceutical company). Phase: Therapeutic exploratory (Phase II). Countries: Germany (ended), Spain (ended), Netherlands (ended), Italy (ended), Poland (ended), France (ended).
Therapeutic area(s): Diseases [C] - Neoplasms [C04]
Gender: Female, Male. Age: 18-64 years, 65+ years. Enrolment: 131.
Status: Ended. Start date (EU): 2016-08-01. End date (EU): 2026-07-28. Decision date: 2024-06-27. Results received: No. Last updated: 2025-09-03.
Decision dates by country: PL: 2024-06-27, IT: 2024-07-01, FR: 2024-06-28, ES: 2024-06-27, NL: 2024-06-28, DE: 2024-06-27

Condition(s): Locally Advanced or Metastatic Solid Tumors that Harbor NTRK1/2/3, ROS1, or ALK Gene Rearrangements
Product: Rozlytrek 200 mg hard capsules

Primary endpoint: Objective Response Rate (ORR), defined as the proportion of patients with complete response (CR) or partial response (PR)
Endpoint(s): Duration of Response (DOR), Time to Response (TTR), Clinical Benefit Rate (CBR), Intracranial tumor response in patients with measurable brain metastases, as determined by BICR using RANO or RANO-BM as applicable, CNS Progression-Free Survival (CNS-PFS) in patients with measurable CNS disease,, Progression-Free Survival (PFS), Overall Survival (OS), Type, incidence, severity, timing, seriousness, and relatedness of adverse events and laboratory abnormalities, Population PK, Ventricular repolarization, Quality-of-life and health status to examine biological markers of bone formation and resorption and markers of calcium metabolism, Assessment of bone mineral density (BMD) via dual X-ray absorptiometry (DXA) scans

Source: https://euclinicaltrials.eu/ctis-public/view/2023-505034-10-00